EU clinical trial 2024-518859-27-00: Effect of ozanimod on meningeal inflammation and glial activation in Multiple Sclerosis: one year phase 4 experimental study PROTOCOL CODE: OZA22 / IM047 - 048
Sponsor: Azienda Ospedaliera Universitaria Integrata Verona (Hospital/Clinic/Other health care facility). Phase: Therapeutic use (Phase IV). Countries: Italy (ongoing, recruiting).
Therapeutic area(s): Diseases [C] - Nervous System Diseases [C10]
Gender: Female, Male. Age: 18-64 years, 65+ years. Enrolment: 50.
Status: Ongoing, recruiting. Start date (EU): 2023-07-06. Decision date: 2024-11-11. Results received: No. Last updated: 2024-11-11.

Condition(s): Relapsing Multiple Sclerosis (relapsing-remitting, relapsing-progressive)
Product: Zeposia 0.92 mg hard capsules

Primary endpoint: CSF (and serum) concentration of CXCL13 protein (ng/ml/mgPro) measured before starting ozanimod treatment (Prebaseline) and at T12.
Endpoint(s): CSF (and serum) concentration of specific markers of activated meningeal inflammation (CXCL12, TNF-a, IFN-¿) (ng/ml/mgPro) measured before starting ozanimod treatment (Prebaseline) and at T12., CSF (and serum) concentration of specific makers of activated microglia/macrophages (Chitinase 3-like1, Osteopontin, sCD163, CX3CL1) (ng/ml/mgPro) measured before starting ozanimod treatment (Prebaseline) and at T12., CSF (and serum) concentration of specific markers of neuronal/axonal damage (neurofilamentlight chains, parvalbumin) (ng/ml/mgPro) measured before starting ozanimod treatment (Prebaseline) and at T12, Number and volume of cortical lesions measured before starting ozanimod treatment (Prebaseline) and at T12, Number and susceptibility of of paramagnetic rim lesions measured before starting ozanimod treatment (Prebaseline), at baseline (T0) and after 1 year of ozanimod treatment (T12), Variation of the volume of white matter lesions before starting ozanimod treatment (¿ prebaseline-T0) and after 1 year of ozanimod treatment (¿ T0-T12), Variation global and regional cortical thickness change before starting ozanimod treatment (¿prebaseline-T0) and after 1 year of ozanimod treatment (¿ T0-T12), Significant linear relationship between the variation of the above-mentioned cytokines (¿ T0-T12) and the EDSS change (¿ T0-T12) or the relapse number by the end of the follow-up (T12)

Source: https://euclinicaltrials.eu/ctis-public/view/2024-518859-27-00